EU clinical trial 2023-503917-31-00: A Randomised, Placebo-Controlled, Double-blind, Single and Multiple Ascending Dose, Phase 1 Study to Evaluate the Safety, Tolerability, and Pharmacokinetics Following Intravenous Administration of IRX-010 in Healthy Participants
Protocol code: IMMURX-01
Sponsor: Immunorx Pharma Inc. (Pharmaceutical company). Phase: Human Pharmacology (Phase I)- First administration to humans. Countries: Netherlands (ended).
Therapeutic area(s): Diseases [C] - Immune System Diseases [C20]
Gender: Female, Male. Age: 18-64 years, 65+ years. Enrolment: 81.
Status: Ended. Start date (EU): 2024-06-24. End date (EU): 2024-09-13. Decision date: 2023-05-10. Results received: No. Last updated: 2024-06-21.

Condition(s): Inflammatory disease

Source: https://euclinicaltrials.eu/ctis-public/view/2023-503917-31-00